EU clinical trial 2023-507220-23-00: MAGNITUDE: A Phase 3, Multinational, Multicenter, Randomized, Double‑Blind, Placebo‑Controlled Study to Evaluate the Efficacy and Safety of NTLA‑2001 in Participants with Transthyretin Amyloidosis with Cardiomyopathy (ATTR‑CM).
Protocol code: ITL-2001-CL-301
Sponsor: Intellia Therapeutics Inc. (Pharmaceutical company). Phase: Therapeutic confirmatory (Phase III). Countries: Italy (ongoing, recruiting), Germany (ongoing, recruiting), France (ongoing, recruiting), Spain (ongoing, recruiting), Sweden (ongoing, recruiting), Denmark (ongoing, recruiting), Portugal (ongoing, recruiting), Netherlands (ongoing, recruiting), Belgium (ongoing, recruiting), Hungary (ongoing, recruiting), Austria (ongoing, recruiting), Poland (ongoing, recruiting), Norway (ongoing, recruiting), Czechia (ongoing, recruiting).
Therapeutic area(s): Diseases [C] - Cardiovascular Diseases [C14]
Gender: Female, Male. Age: 18-64 years, 65+ years. Enrolment: 379.
Status: Ongoing, recruiting. Start date (EU): 2026-07-13. Decision date: 2024-06-05. Results received: No. Last updated: 2026-07-27.
Decision dates by country: PT: 2024-09-02, ES: 2024-06-06, CZ: 2024-10-18, DK: 2024-06-06, PL: 2024-10-07, AT: 2024-08-26, SE: 2024-06-10, HU: 2024-09-13, BE: 2024-09-09, FR: 2024-06-05, DE: 2024-06-10, NL: 2024-09-24, IT: 2024-06-06, NO: 2024-10-03

Condition(s): Transthyretin Amyloidosis with Cardiomyopathy
Product: Famotidin STADA® 20 mg Filmtabletten, Dexamethason 8 mg GALEN® Tabletten, Cetirizin HEXAL bei Allergien 10 mg Filmtabletten, Paracetamol STADA® 500 mg Tabletten, NTLA-2001

Primary endpoint: Composite outcome of cardiovascular (CV) mortality and CV events
Endpoint(s): 1. Change from baseline to month 18 in serum TTR, 2. Change from baseline to month 18 in KCCQ-OS score

Source: https://euclinicaltrials.eu/ctis-public/view/2023-507220-23-00